EU clinical trial 2024-519551-29-00: A multicentric, randomized, double-blind, parallel, placebo-controlled phase III study to assess the safety and efficacy of sovateltide in patients with acute cerebral ischemic stroke.
Protocol code: Sovateltide/ACIS/IND
Sponsor: Pharmazz EU Limited (Pharmaceutical company). Phase: Therapeutic confirmatory (Phase III). Countries: Germany (authorised, recruitment pending), Spain (ongoing, recruiting).
Therapeutic area(s): Diseases [C] - Cardiovascular Diseases [C14]
Gender: Female, Male. Age: 18-64 years, 65+ years. Enrolment: 262.
Start date (EU): 2025-08-21. Decision date: 2025-06-16. Results received: No. Last updated: 2026-03-09.
Decision dates by country: DE: 2025-06-16, ES: 2025-06-16

Condition(s): Acute cerebral ischemic stroke
Product: Sovateltide, Sovateltide matching placebo

Primary endpoint: The primary efficacy endpoint of the study is the proportion of acute cerebral ischemic stroke patients having a good functional outcome with a modified Rankin Scale score of 0-2 on day 90 post-randomization.
Endpoint(s): The proportion of acute cerebral ischemic stroke patients having a good functional outcome with NIHSS score of <6 on day 90 post-randomization., The proportion of acute cerebral ischemic stroke patients having a good functional outcome with BI score of ≥90 on day 90 post-randomization., The proportion of acute cerebral ischemic stroke patients having an excellent functional outcome with a modified Rankin Scale score of 0-1 on day 90 post-randomization., Change in QoL as assessed by EuroQol EQ-5D-5L and by SS-QOL from baseline to days 30, 60, and 90 post-randomization., The proportion of patients with recurrent ischemic stroke within 90 days post-randomization., Number of deaths within day 90 post-randomization., The proportion of patients with symptomatic ICH within 24 (± 6) hours of randomization., The proportion of patients with radiographic ICH within 24 (± 6) hours of randomization., Change in MoCA score at days 30 and 90 post-randomization., The proportion of patients with adverse events (AEs) and serious adverse events (SAEs).

Source: https://euclinicaltrials.eu/ctis-public/view/2024-519551-29-00